EU clinical trial 2024-515378-28-00: A FIRST-IN-HUMAN PHASE I TRIAL OF OX118 IN HEALTHY VOLUNTEERS
Protocol code: SAPIOX
Sponsor: Oxion Biologics AB (Pharmaceutical company). Phase: Human Pharmacology (Phase I)- First administration to humans. Countries: Sweden (ended).
Therapeutic area(s): Diseases [C] - Immune System Diseases [C20]
Gender: Female, Male. Age: 18-64 years. Enrolment: 32.
Status: Ended. Start date (EU): 2025-04-03. End date (EU): 2025-10-30. Decision date: 2025-03-19. Results received: No. Last updated: 2025-03-19.

Condition(s): Immune system Diseases

Source: https://euclinicaltrials.eu/ctis-public/view/2024-515378-28-00